EU clinical trial 2025-522923-81-00: A multicenter, prospective clinical TRrial evaluating patient’s ability to make an independent and safe decision regarding the USe of the medicinal product Sildenafil Polpharma100 mg indicated in the Treatment of erectile dysfunction. TRUST Trial on Responsible Use and Self-assessed Treatment.
Protocol code: 844700336/0156/1
Sponsor: ZAKLADY FARMACEUTYCZNE POLPHARMA S.A. (Pharmaceutical company). Phase: Therapeutic use (Phase IV). Countries: Poland (ended).
Therapeutic area(s): Diseases [C] - Male Urogenital Diseases [C12]
Gender: Male. Age: 18-64 years, 65+ years. Enrolment: 200.
Status: Ended. Start date (EU): 2026-02-17. End date (EU): 2026-04-14. Decision date: 2026-01-26. Results received: No. Last updated: 2026-03-23.

Condition(s): Erectile dysfunction
Product: MAXIGRA, 100 mg, tabletki powlekane

Primary endpoint: Not for public
Endpoint(s): Not for public, In regards to participants who receive IMP: ▪ Compliance - proportion of participants taking sildenafil as prescribed ▪ Efficacy - proportion of participants who report efficacy of used medication (whether administration of an IMP allowed for achieving and maintaining a penile erection sufficient for efficient sexual intercourse). ▪ Efficacy - proportion of satisfying sexual intercourses after administration sildenafil 100 mg (assessed per participant and per study population). ▪ Safety – number

Source: https://euclinicaltrials.eu/ctis-public/view/2025-522923-81-00